EU clinical trial 2024-514078-29-00: Open-label non-randomized multicentric phase 2 study evaluating the combination of bemarituzumab + FLOT chemotherapy in perioperative setting for resectable stage cT2-T4a or N+ gastric and GEJ adenocarcinoma overexpressing FGFR2b (BEMAFLOT)
Protocol code: ICO-2023-10
Sponsor: Institut De Cancerologie De L Ouest (Hospital/Clinic/Other health care facility). Phase: Therapeutic exploratory (Phase II). Countries: France (ended).
Therapeutic area(s): Diseases [C] - Digestive System Diseases [C06]
Gender: Female, Male. Age: 18-64 years, 65+ years. Enrolment: 49.
Status: Ended. End date (EU): 2025-11-07. Decision date: 2025-05-26. Results received: No. Last updated: 2025-10-02.

Condition(s): gastric and gastro-oesophageal junction adenocarcinomas
Product: LEVOFOLINATE DE CALCIUM ZENTIVA 10 mg/ml, solution injectable (IM/IV), Docetaxel Accord 20 mg/1 ml concentrate for solution for infusion, Bemarituzumab, FLUOROURACILE ACCORD 50 mg/ml, solution à diluer pour perfusion, OXALIPLATINE ACCORD 5 mg/ml, solution à diluer pour perfusion

Primary endpoint: the complete pathological response in histological result of primary tumour and lymph nodes from the surgical resection, using Becker tumour resection grading (21).
Endpoint(s): Adverse Events (AE), Serious Adverse Events (SAE), assessed by CTCAE version 5.0 and specific grading for ocular toxicity cf. section .9.1.1 (start, imputability), Post-operative complications, graded using Clavien-Dindo scale, between surgery and 30 days postoperative, Histological results of the primary tumour and lymph nodes from the surgical resection, using Becker tumour grading, • Vital status throughout the 5 years follow-up • TDM every 3 months for 2 years and every 6 months until 5 years of follow-up. Recurrence is defined according to RECIST 1.1., • Vital status throughout the 5 years follow-up • TDM every 3 months for 2 years and every 6 months until the 5-years-follow-up. Recurrence is defined according RECIST 1.1., EORTC QLQ-C30 at C1D1, after surgery, at the end of treatment (EOT) visit and then every 6 months for 5 years., The nutritional status assessment will be assessed by Mini Nutritional Assessment (MNA)(23), at C1D1, after surgery, at the EOT visit and every 6 months for 5 years. The MNA (23–26) provided a global score of nutritional status from 0 to 30 and identify 3 categories: normal (≥24), at risk of malnutrition (≥17) and malnourished (<17)., • The expression of FGFR2b is measured prior to inclusion in the trial, during the screening period. • Vital status throughout the 5 years follow-up • TDM every 3 months for 2 years and every 6 months until the 5-years-follow-up. Recurrence is defined according RECIST 1.1.

Source: https://euclinicaltrials.eu/ctis-public/view/2024-514078-29-00